EU clinical trial 2025-522027-95-00: Fluorescence Intraoperative Surgical Margin Analysis in Head and Neck Cancer: Clinical Validation
Sponsor: Universitair Medisch Centrum Groningen (Hospital/Clinic/Other health care facility). Phase: Therapeutic confirmatory (Phase III). Countries: Netherlands (authorised, recruitment pending).
Therapeutic area(s): Diseases [C] - Neoplasms [C04]
Gender: Female, Male. Age: 18-64 years, 65+ years. Enrolment: 120.
Status: Authorised, recruitment pending. Decision date: 2026-01-19. Results received: No. Last updated: 2026-03-03.
Decision dates by country: NL: 2026-02-26

Condition(s): oral squamous cell carcinoma
Product: CETUXIMAB

Primary endpoint: Compare surgical outcome in terms of margin status between the intervention cohort and the standard of care cohort
Endpoint(s): Determining diagnostic parameters (including predictive values, sensitivity, specificity, type I & II errors) of fluorescence imaging for identifying inadequate tumor margins., Implementation of an intraoperative feedback workflow between the pathology department and surgery team on the margin assessment by FI., Retrospective comparison between standard fluorescence imaging devices and a novel technique using dual aperture fluorescence imaging as an exploratory objective.

Source: https://euclinicaltrials.eu/ctis-public/view/2025-522027-95-00